EU clinical trial 2023-504671-24-00: A double-blind, randomized, placebo-controlled, dose-escalating Phase I trial to determine the safety, pharmacokinetic parameters, and clinical effects of single subcutaneous injections of IGX12 in healthy female and male participants
Protocol code: PRO-2022-009
Sponsor: Igyxos (Pharmaceutical company). Phase: Human Pharmacology (Phase I)- First administration to humans. Countries: Germany (ended).
Therapeutic area(s): Diseases [C] - Female Urogenital Diseases and Pregnancy Complications [C13]; Diseases [C] - Male Urogenital Diseases [C12]
Gender: Female, Male. Age: 18-64 years. Enrolment: 48.
Status: Ended. Start date (EU): 2023-09-22. End date (EU): 2025-07-25. Decision date: 2023-09-15. Results received: No. Last updated: 2024-08-01.

Condition(s): Men and women infertility

Source: https://euclinicaltrials.eu/ctis-public/view/2023-504671-24-00